EU clinical trial 2024-515351-37-00: A Study of ImmunoPet Imaging Using 89Zr-DFO-REGN5054 in Adult Participants with Solid Cancers Treated with Cemiplimab
Protocol code: R5054-ONC-1843
Sponsor: Regeneron Pharmaceuticals Inc. (Pharmaceutical company). Phase: Human Pharmacology (Phase I)- First administration to humans. Countries: Netherlands (ongoing, recruiting).
Therapeutic area(s): Diseases [C] - Neoplasms [C04]
Gender: Female, Male. Age: 18-64 years, 65+ years. Enrolment: 40.
Status: Ongoing, recruiting. Start date (EU): 2023-02-07. Decision date: 2024-09-17. Results received: No. Last updated: 2026-06-24.

Condition(s): Advanced Solid Tumor

Source: https://euclinicaltrials.eu/ctis-public/view/2024-515351-37-00